EU clinical trial 2023-509573-23-00: A Phase 2a, Open-Label Multiple Dose Study Evaluating the Safety, Tolerability, and Pharmacodynamics of Imdusiran (AB-729) in Combination with Intermittent Dosing of Durvalumab, a PD-L1 Monoclonal Antibody, in Subjects with Chronic HBV Infection
Protocol code: AB-729-203
Sponsor: Arbutus Biopharma Inc. (Pharmaceutical company). Phase: Therapeutic exploratory (Phase II). Countries: France (ended), Spain (ended), Poland (ended), Romania (ended).
Therapeutic area(s): Diseases [C] - Immune System Diseases [C20]
Gender: Female, Male. Age: 18-64 years. Enrolment: 13.
Status: Ended. Start date (EU): 2024-07-16. End date (EU): 2024-08-01. End date: 2024-08-02. Decision date: 2024-06-10. Results received: No. Last updated: 2024-06-28.
Decision dates by country: FR: 2024-06-11, RO: 2024-06-28, ES: 2024-06-10, PL: 2024-06-14

Condition(s): Chronic HBV Infection
Product: Imdusiran, IMFINZI 50 mg/mL concentrate for solution for infusion.

Primary endpoint: The frequency and severity of treatment emergent adverse events (TEAEs) and irAEs, and discontinuations due to AEs and irAEs, The frequency and severity of laboratory abnormalities by cohort, Vital signs, physical exam and electrocardiogram (ECG) abnormalities

Source: https://euclinicaltrials.eu/ctis-public/view/2023-509573-23-00